EU clinical trial 2024-518768-11-02: A model of a sterile, self-limiting, acute inflammatory response in healthy volunteers using lipopolysaccharides – a platform trial
Protocol code: Vienna-LPS-Platform
Sponsor: Medical University Of Vienna (Educational Institution). Phase: Human Pharmacology (Phase I)- Other. Countries: Austria (ongoing, recruiting).
Therapeutic area(s): Not possible to specify
Gender: Female, Male. Age: 18-64 years. Enrolment: 16.
Status: Ongoing, recruiting. Start date (EU): 2023-05-19. Decision date: 2024-12-11. Results received: No. Last updated: 2024-12-11.

Condition(s): Healthy volunteers

Source: https://euclinicaltrials.eu/ctis-public/view/2024-518768-11-02